EU clinical trial 2023-508541-41-00: A Phase 2a Safety, Tolerability, and Pharmacodynamic Study of OMT-28 in PMD patients with myopathy and/or cardiomyopathy and inflammation (PMD-OPTION)
Sponsor: OMEICOS Therapeutics GmbH (Pharmaceutical company). Phase: Therapeutic exploratory (Phase II). Countries: Germany (ended), Italy (ended), Netherlands (ended).
Therapeutic area(s): Diseases [C] - Congenital, Hereditary, and Neonatal Diseases and Abnormalities [C16]
Gender: Female, Male. Age: 18-64 years. Enrolment: 42.
Status: Ended. Start date (EU): 2023-05-22. End date (EU): 2025-05-14. Decision date: 2023-12-12. Results received: Yes. Last updated: 2024-05-27.
Decision dates by country: DE: 2023-12-12, IT: 2023-12-13, NL: 2024-05-27

Condition(s): Primary Mitochondrial Disease
Product: OMT-28_24mg_cap

Primary endpoint: Primary Efficacy Endpoint: Number of patients (responder rate) with a between phase difference in GDF-15 of at least 20% decrease after 12 weeks of treatment., Primary Safety Endpoints: Incidence, severity, seriousness, reported causality, and duration of TEAEs, clinically significant changes in safety laboratory, vital signs, and 12-lead ECG

Source: https://euclinicaltrials.eu/ctis-public/view/2023-508541-41-00